EU clinical trial 2024-519358-35-00: An open-label phase 2/3 study to analyse the feasibility and evaluate the safety of intravenous administration of 99mTc-PSMA-T4 in patients with prostate cancer
Protocol code: PSMA-T4_2021
Sponsor: Narodowe Centrum Badan Jadrowych (Laboratory/Research/Testing facility). Phase: Phase II and Phase III (Integrated). Countries: Poland (ended).
Therapeutic area(s): Diseases [C] - Neoplasms [C04]
Gender: Male. Age: 18-64 years, 65+ years. Enrolment: 80.
Status: Ended. End date (EU): 2026-06-26. Decision date: 2025-01-29. Results received: No. Last updated: 2026-04-15.

Condition(s): Feasibility analysis and safety evaluation of [99mTc]Tc-PSMA-T4 in prostate cancer diagnosis and treatment planning.
Product: PSMA-T4 kit for Tc-99m labelling

Primary endpoint: The diagnostic method will be deemed a feasible approach if at least 80% of subjects in each cohort fulfil the criteria of sensitivity and specificity (for cohorts A and B only, due to lack of negative results in cohort C as consequence of inclusion criteria) of [99mTc]Tc-PSMA-T4 multi-SPECT/CT – detection of all lesions that are pathologically or radiologically confirmed or suspicious in other modalities recommended in a particular clinical situation.
Endpoint(s): Positive and negative predictive value: Positive predictive value defined as number of true positives x 100% / number of true positives + number of false positives Negative predictive value defined as number of true negatives x 100% / number of true negatives + number of false negatives. Safety: Frequency of adverse events (AEs).The procedure-related AEs will be recorded during the 24h of the follow-up period in each case,no later than 48h after drug administration.Dosimetry, Feasibility.

Source: https://euclinicaltrials.eu/ctis-public/view/2024-519358-35-00